EU clinical trial 2023-505116-37-00: Exploratory evaluation of the effect of cholestyramine on serum levels of persistent organic pollutants in obese patients
Protocol code: 21-AOI-07
Sponsor: Centre Hospitalier Universitaire De Nice (Hospital/Clinic/Other health care facility). Phase: Therapeutic exploratory (Phase II). Countries: France (ongoing, recruiting).
Therapeutic area(s): Diseases [C] - Hormonal diseases [C19]
Gender: Female. Age: 18-64 years. Enrolment: 40.
Status: Ongoing, recruiting. Start date (EU): 2024-02-08. Decision date: 2023-06-14. Results received: No. Last updated: 2026-04-27.

Condition(s): Obesity
Product: QUESTRAN 4 g, poudre orale en sachet

Primary endpoint: Serum concentration of persistent organic pollutants between M0 (pre-surgery) and M4 (post-surgery)
Endpoint(s): Measurement of serum concentrations of persistants organics pollutants by mass spectrometry after bariatric surgery and determination of their evolution in relation to expected release.

Source: https://euclinicaltrials.eu/ctis-public/view/2023-505116-37-00